EU clinical trial 2024-512700-18-00: Long-Term Follow-up of Fabry Disease Subjects who were Treated with ST-920, an AAV2/6 Human Alpha Galactosidase A Gene Therapy
Protocol code: ST-920-LT01
Sponsor: Sangamo Therapeutics Inc. (Pharmaceutical company). Phase: Therapeutic exploratory (Phase II). Countries: Germany (ongoing, recruitment ended).
Therapeutic area(s): Diseases [C] - Congenital, Hereditary, and Neonatal Diseases and Abnormalities [C16]
Gender: Male. Age: 18-64 years, 65+ years. Enrolment: 1.
Status: Ongoing, recruitment ended. Start date (EU): 2025-04-03. Decision date: 2025-01-31. Results received: No. Last updated: 2026-05-19.

Condition(s): Fabry Disease (X-linked lysosomal storage disease).
Product: ST-920

Primary endpoint: To evaluate long-term safety of ST-920 by assessment of incidence and severity of adverse events (AEs)

Source: https://euclinicaltrials.eu/ctis-public/view/2024-512700-18-00